EU clinical trial 2024-514388-24-00: A Phase 2, Randomized, Double-Blind, Placebo-Controlled, Multicenter Study Evaluating the Safety and Efficacy of PPV-06 Active Immunotherapy in Patients with Inflammatory Knee Osteoarthritis (KOA).
Protocol code: PPV-06-KOA-201
Sponsor: Peptinov (Pharmaceutical company). Phase: Therapeutic exploratory (Phase II). Countries: Romania (authorised, recruitment pending), Poland (authorised, recruitment pending), France (authorised, recruitment pending), Denmark (authorised, recruitment pending), Czechia (authorised, recruitment pending).
Therapeutic area(s): Diseases [C] - Musculoskeletal Diseases [C05]
Gender: Female, Male. Age: 18-64 years, 65+ years. Enrolment: 204.
Status: Authorised, recruitment pending. Decision date: 2024-12-02. Results received: No. Last updated: 2026-04-13.
Decision dates by country: CZ: 2024-12-05, DK: 2024-12-03, FR: 2024-12-02, RO: 2024-12-09, PL: 2024-12-09

Condition(s): Knee osteoarthritis
Product: Panodil, filmovertrukne tabletter, PPV-06, Matching Placebo

Primary endpoint: Absolute change from baseline to Week 54 of the pain subscale score of the Western Ontario and McMaster Universities Osteoarthritis Index (WOMAC) (5 items), Absolute change from baseline to Week 54 of the WOMAC physical function subscale score (17 items)
Endpoint(s): Absolute change from baseline to Week 54 of Synovitis based on 11-point synovitis score, Absolute change from baseline in cartilage thickness (ThC) in the medial femorotibial compartment (MFTC), assessed by MRI at 2 years (Week 104) using quantitative image analysis method

Source: https://euclinicaltrials.eu/ctis-public/view/2024-514388-24-00